EU clinical trial 2025-520468-16-00: Efficacy and Safety Study of Acasunlimab as Monotherapy and in Combination With Pembrolizumab in Subjects With Relapsed/Refractory, Unresectable Locally Advanced or Metastatic Cutaneous Melanoma That Progressed On or After Treatment With a Checkpoint Inhibitor
Protocol code: GCT1046-07
Sponsor: Genmab A/S (Pharmaceutical company). Phase: Therapeutic exploratory (Phase II). Countries: France (ended), Spain (ended), Netherlands (ended), Germany (ended).
Therapeutic area(s): Diseases [C] - Neoplasms [C04]
Gender: Female, Male. Age: 18-64 years, 65+ years. Enrolment: 129.
Status: Ended. End date (EU): 2026-01-19. End date: 2026-05-15. Decision date: 2025-10-23. Results received: No. Last updated: 2025-10-27.
Decision dates by country: FR: 2025-10-27, DE: 2025-10-27, ES: 2025-10-24, NL: 2025-10-23

Condition(s): Cutaneous Melanoma, Relapsed/Refractory, Locally Advanced Unresectable Melanoma (Stage IIIB, IIIC, or IIID), Metastatic Cutaneous Melanoma (Stage IV)
Product: Acasunlimab, KEYTRUDA 25 mg/mL concentrate for solution for infusion

Primary endpoint: Objective response rate (ORR) assessed by the investigator per Response Evaluation Criteria in Solid Tumors (RECIST) v1.1

Source: https://euclinicaltrials.eu/ctis-public/view/2025-520468-16-00